EU clinical trial 2024-510658-28-00: A Phase 2b, Randomized, Placebo-Controlled, Double-Blind, Parallel Group Dose-Finding Clinical Study to Evaluate the Efficacy and Safety of RMC-035 in Participants at High Risk for Kidney Injury Following Open-Chest Cardiac Surgery
Protocol code: 24-ROS-07
Sponsor: Guard Therapeutics International AB (publ) (Pharmaceutical company). Phase: Therapeutic exploratory (Phase II). Countries: Czechia (ended), Spain (ended), Germany (ended).
Therapeutic area(s): Diseases [C] - Male Urogenital Diseases [C12]; Diseases [C] - Female Urogenital Diseases and Pregnancy Complications [C13]
Gender: Female, Male. Age: 18-64 years, 65+ years. Enrolment: 124.
Status: Ended. Start date (EU): 2024-09-24. End date (EU): 2025-09-05. End date: 2025-09-12. Decision date: 2024-08-05. Results received: Yes. Last updated: 2025-05-22.
Decision dates by country: DE: 2024-08-06, ES: 2024-08-05, CZ: 2024-08-07

Condition(s): Loss of renal function following cardiac surgery
Product: RMC-035, An aqueous clear, colorless to slightly yellow solution.

Primary endpoint: Change from baseline in eGFR based on SCr at Day 90 (pooled low and high dose levels)
Endpoint(s): Occurrence of MAKE (and each MAKE component) at Day 90 (pooled low and high doses, and by each dose level), Change from Baseline in eGFR based on SCr at Day 90 (low and high doses, respectively)

Source: https://euclinicaltrials.eu/ctis-public/view/2024-510658-28-00